EU clinical trial 2022-500691-59-00: A Randomized, Double-Blind, Placebo-Controlled Study to Evaluate the Safety, Efficacy, Pharmacokinetics and Pharmacodynamics of ABBV-916 in Subjects with Early Alzheimer's Disease
Protocol code: M22-721
Sponsor: Abbvie Deutschland GmbH & Co. KG (Pharmaceutical company). Phase: Therapeutic exploratory (Phase II). Countries: Portugal (ended), Italy (ended), Spain (ended).
Therapeutic area(s): Diseases [C] - Nervous System Diseases [C10]
Gender: Female, Male. Age: 18-64 years, 65+ years. Enrolment: 98.
Status: Ended. End date (EU): 2024-06-27. Decision date: 2023-07-28. Results received: No. Last updated: 2024-06-03.
Decision dates by country: ES: 2023-08-01, IT: 2023-07-28, PT: 2023-07-31

Condition(s): Alzheimer's disease (AD)
Product: Placebo, MK-6240, ABBV-916

Primary endpoint: The primary efficacy endpoint for Stage B is change from Baseline in brain amyloid plaque deposition (amyloid centiloid value) at Week 24 as measured by amyloid PET scan.

Source: https://euclinicaltrials.eu/ctis-public/view/2022-500691-59-00